EU clinical trial 2023-504724-25-00: A Phase 3, Randomized, Double-blind, Add-on Study Evaluating the Safety and Efficacy of Navtemadlin Plus Ruxolitinib vs Placebo Plus Ruxolitinib in Patients with Myelofibrosis Who Have a Suboptimal Response to Ruxolitinib
Protocol code: KRT-232-115
Sponsor: Kartos Therapeutics Inc. (Pharmaceutical company). Phase: Therapeutic confirmatory (Phase III). Countries: Belgium (ongoing, recruiting), France (ongoing, recruiting), Portugal (ongoing, recruiting), Hungary (ongoing, recruiting), Greece (ongoing, recruiting), Spain (ongoing, recruiting), Poland (ongoing, recruiting), Italy (ongoing, recruiting), Germany (ongoing, recruiting), Czechia (ongoing, recruiting), Austria (ongoing, recruiting), Romania (ongoing, recruiting), Croatia (ongoing, recruiting).
Therapeutic area(s): Diseases [C] - Neoplasms [C04]
Gender: Female, Male. Age: 18-64 years, 65+ years. Enrolment: 126.
Status: Ongoing, recruiting. Start date (EU): 2024-10-16. Decision date: 2024-09-17. Results received: No. Last updated: 2026-06-02.
Decision dates by country: DE: 2024-09-18, GR: 2024-09-18, RO: 2024-09-23, IT: 2024-09-18, HU: 2024-09-17, AT: 2024-09-22, FR: 2024-09-17, CZ: 2024-09-19, HR: 2024-09-22, ES: 2024-09-23, PT: 2024-09-23, BE: 2024-09-17, PL: 2024-09-22

Condition(s): Primary Myelofibrosis, Secondary Myelofibrosis (including but not limited to myelofibrosis post-Polycythemia Vera or post-Essential Thrombocythemia)
Product: Placebo to match EU-sourced loperamide, capsule, Navtemadlin 25-30, Placebo to match US-sourced loperamide, capsule, Placebo to match navtemadlin 60mg, film-coated tablet, Navtemadlin 25-120, Navtemadlin 25-60, RUXOLITINIB, RUXOLITINIB, Placebo to match navtemadlin 180mg, film-coated tablet, Navtemadlin (KRT-232), Placebo to match ondansetron, capsule, RUXOLITINIB, RUXOLITINIB, LOPERAMID WZF, 2 mg, tabletki, LOPERAMIDE HYDROCHLORIDE, ONDANSETRON, Placebo to match navtemadlin 120mg, film-coated tablet, Placebo to match navtemadlin 30mg, film-coated tablet

Primary endpoint: SVR will be evaluated 24 weeks after randomized treatment begins by MRI/CT scan (central review)., TSS reduction will be evaluated 24 weeks after randomized treatment begins using the Myelofibrosis Symptom Assessment Form (MFSAF) v4.0.
Endpoint(s): The proportion of patients who have spleen volume reduction between Arm 1 and Arm 2, The proportion of patients who have TSS reduction between Arm 1 and Arm 2, Time to death from any cause in patients randomized to each arm, Time to progression or death from any cause in patients randomized to each arm, Analyses of the safety endpoints will include the following measurements or assessments: physical examinations, laboratory tests, adverse events (AEs), serious AEs (SAEs), electrocardiograms (ECGs), and vital signs, Change in SVR 24 weeks after the randomized treatment begins, Change in TSS 24 weeks after the randomized treatment begins

Source: https://euclinicaltrials.eu/ctis-public/view/2023-504724-25-00